EU clinical trial 2023-506986-74-00: An Open-Label, Multicenter, Phase Ib/II Trial Evaluating the Safety, Tolerability, Pharmacokinetics, and Efficacy of Mosunetuzumab (BTCT4465A) in Combination with Polatuzumab Vedotin in Patients with B-Cell Non-Hodgkin Lymphoma
Protocol code: GO40516
Sponsor: F. Hoffmann-La Roche AG (Pharmaceutical company). Phase: Phase I and Phase II (Integrated)- Other. Countries: Spain (ongoing, recruitment ended), Belgium (ongoing, recruitment ended).
Therapeutic area(s): Diseases [C] - Neoplasms [C04]; Diseases [C] - Hemic and Lymphatic Diseases [C15]
Gender: Female, Male. Age: 18-64 years, 65+ years. Enrolment: 17.
Status: Ongoing, recruitment ended. Start date (EU): 2021-12-27. Decision date: 2023-11-28. Results received: No. Last updated: 2026-07-14.
Decision dates by country: ES: 2023-11-28, BE: 2023-12-19

Condition(s): B-cell non-Hodgkin lymphoma (NHL)
Product: Mosunetuzumab, FLUDEOXYGLUCOSE (18F), Mosunetuzumab, DIPHENHYDRAMINE, METHYLPREDNISOLONE, MabThera 500 mg concentrate for solution for infusion, Mosunetuzumab, PEGFILGRASTIM, PREDNISONE, Polivy 140 mg powder for concentrate for solution for infusion., RASBURICASE, RoActemra 20 mg/mL concentrate for solution for infusion, DEXAMETHASONE, Mosunetuzumab, PARACETAMOL, ALLOPURINOL

Primary endpoint: 1. Occurrence and severity of adverse events, including DLTs (Phase Ib), 2. Change from baseline in targeted vital signs (Phase Ib), 3. Change from baseline in targeted clinical laboratory test results (Phase Ib), 4. CR rate at the time of PRA as determined by the investigator (Phase Ib), 5. Best ORR as determined by the investigator (Phase Ib), 6. DOR as determined by the investigator (Phase Ib), 7. Best ORR, as determined by the IRC (Phase II)
Endpoint(s): 1. Best ORR as determined by the investigator (Phase II), 2. Best CR rate as determined by the investigator and IRC (Phase II), 3. CR rate at the time of PRA as determined by the investigator and IRC (Phase II), 4. ORR at the time of PRA as determined by the investigator and IRC (Phase II), 5. DOR as determined by the investigator and IRC (Phase II), 6. PFS as determined by the investigator and IRC (Phase II), 7. EFS as determined by the investigator and IRC (Phase II), 8. OS (Phase II), 9. Occurrence and severity of adverse events (Phase II), 10. Change from baseline in targeted vital signs (Phase II), 11. Change from baseline in targeted clinical laboratory test results (Phase II), 12. Maximum serum concentration (Cmax) for Mosun (Phase Ib and II), 13. Minimum serum concentration (Cmin) for Mosun (Phase Ib and II), 14. Total exposure area under the concentration-time curve (AUC) for Mosun (Phase Ib and II), 15. Clearance for Mosun (Phase Ib and II), 16. Volume of distribution for Mosun (Phase Ib and II), 17. Relationship between ADA status and efficacy, safety, pharmacokinetics, and biomarkers (Phase Ib and II)

Source: https://euclinicaltrials.eu/ctis-public/view/2023-506986-74-00